EU clinical trial 2023-506027-29-00: Biological Medicine for Diffuse Intrinsic Pontine Glioma (DIPG) Eradication: BIOMEDE 2.0
Protocol code: CSET 2014/2126
Sponsor: Institut Gustave Roussy (Hospital/Clinic/Other health care facility). Phase: Therapeutic confirmatory (Phase III). Countries: Denmark (ongoing, recruiting), France (ongoing, recruiting), Sweden (ongoing, recruiting), Spain (ongoing, recruiting), Finland (authorised, recruitment pending), Norway (authorised, recruitment pending), Greece (authorised, recruitment pending).
Therapeutic area(s): Diseases [C] - Neoplasms [C04]
Gender: Female, Male. Age: 0-17 years, 18-64 years, 65+ years. Enrolment: 446.
Start date (EU): 2014-10-01. Decision date: 2024-10-10. Results received: No. Last updated: 2026-07-14.
Decision dates by country: DK: 2024-10-15, ES: 2024-10-10, FR: 2024-10-16, SE: 2024-10-15, FI: 2026-06-23, NO: 2026-07-02, GR: 2026-07-14

Condition(s): Children, adolescents and adults with newly diagnosed diffuse intrinsic pontine glioma and other diffuse midline gliomas H3K28M mutant or EZHIP positive
Product: Afinitor 2.5 mg tablets, Afinitor 10 mg tablets

Primary endpoint: Progression-free survival from randomization defined as the time between date of randomization and unequivocal clinical, cytological or radiological progression confirmed by central review, or death whatever the cause. In case of cytological progression in the CSF only, the date of progression will be the date of the CSF analysis. The main analysis will be based on the entire progression-free survival curve. Progression will be defined according to the RANO and RAPNO criteria (see Appendix 3).
Endpoint(s): For all the comparisons to historical controls, overall survival will be defined from the date of radiological diagnosis to the date of death from any cause., Progression-free survival after first progression will also be computed from the date of progression to the date of subsequent progression or death from any cause, in order to describe the outcome after progression, Safety of the diagnostic biopsy-based procedure will be evaluated by the complication rate, the severity of the complications (including prolongation of the hospital stay) and their duration (including delay for starting treatment)., Safety profile of the drugs will be assessed using the NCI-CTCAE v5.0 criteria, during radiotherapy and during the entire duration of the administration of the drug, considering all adverse events except AE obviously related to the underlying disease, progression or the pseudo-progression, The relative benefit/risk ratio of ONC201 compared to everolimus will be assessed using the Q-TWiST approach (Quality-adjusted time without symptoms of disease or adverse event) evaluated from survival times (overall survival and progression-free survival) and adverse events data (date of occurrence of grade 3+ adverse event) as detailed in the statistical considerations.

Source: https://euclinicaltrials.eu/ctis-public/view/2023-506027-29-00